EU clinical trial 2024-518386-95-02: Phase II single arm study with CABozantinib in Non-Small Cell Lung Cancer patients with MET deregulation
Protocol code: CABinMET
Sponsor: Fondazione Ricerca Traslazionale (Laboratory/Research/Testing facility). Phase: Therapeutic exploratory (Phase II). Countries: Italy (authorised, recruitment pending).
Therapeutic area(s): Diseases [C] - Neoplasms [C04]
Gender: Female, Male. Age: 18-64 years, 65+ years. Enrolment: 25.
Status: Authorised, recruitment pending. Decision date: 2025-02-20. Results received: No. Last updated: 2026-08-06.

Condition(s): Non small-cell lung cancer
Product: CABOMETYX 60 mg film-coated tablets, CABOMETYX 20 mg film-coated tablets, CABOMETYX 40 mg film-coated tablets

Primary endpoint: Response Rate (RR) (complete + partial responses) of Cabozantinib in NSCLC patients with MET amplification or MET exon 14 skipping mutation pre-treated or not with MET inhibitors.
Endpoint(s): - Progression free survival (PFS) - Overall survival (OS) - Disease Control Rate (DCR: stable disease + partial response + complete response) - Exploratory biomarkers on blood and tissue samples (for each patient enrolled in the study optionally a tissue sample could be provided at disease progression)

Source: https://euclinicaltrials.eu/ctis-public/view/2024-518386-95-02